EU clinical trial 2023-505285-28-01: EXL-01 in combination with nivolumab for advanced NSCLC refractory to immunotherapy'
Protocol code: DRI_2022/0641
Sponsor: Centre Hospitalier Universitaire De Lille (Hospital/Clinic/Other health care facility). Phase: Phase I and Phase II (Integrated)- Other. Countries: France (ongoing, recruiting).
Therapeutic area(s): Phenomena and Processes [G] - Circulatory and Respiratory Physiological Phenomena [G09]
Gender: Female, Male. Age: 18-64 years, 65+ years. Enrolment: 21.
Status: Ongoing, recruiting. Start date (EU): 2024-07-16. Decision date: 2024-04-05. Results received: No. Last updated: 2026-07-20.

Condition(s): Patients (male or female) ≥18 years old with histologically or cytologically documented inoperable advanced/metastatic Non-Small-Cell Lung Cancer (NSCLC)
Product: OPDIVO 10 mg/mL concentrate for solution for infusion., EXL01

Primary endpoint: The progression-free survival rate (PFS Rate) at 3 months for the assessment of efficacy, defined as the rate of alive and non-progressive subjects as per iRECIST 1.1 over the study subjects, at 3 months from the inclusion.
Endpoint(s): The number of Grade ≥ 3 treatment-related AE, using CTCAE, occurring during the first 6 weeks of treatment., The Progression Free Survival, defined as the time from inclusion to the first documented disease progression or death due to any cause, whichever occurs first., The ORR (Overall Response Rate) as per iRECIST1.1 for the assessment of efficacy, defined as the rate of confirmed Complete Response (CR) or Partial Response (PR) over the study subjects efficacy responses., The Overall Survival, defined as the time from inclusion to the date of death due to any cause., The Disease Control Rate, defined as the rate of confirmed Complete Response (CR), or Partial Response (PR), or Stable Disease (SD) over the study subjects efficacy responses., The Duration of Response, for participants who demonstrate confirmed CR or PR, defined as the time from first documented evidence of CR or PR until disease progression or death due to any cause, whichever occurs first., The frequency, type and grade of adverse events, using CTCAE version 5, from the inclusion to the end of the follow-up period, for every patients included., The number of discontinuations of study intervention due to an adverse event., The molecular (genomic, metabolic, proteomic) determinants of response or resistance to treatment (PFS at 3 months), using blood samples and/or tumor tissue., The immune and microbial determinants of response or resistance (PFS at 3 months) or tolerability to treatment (number of Grade ≥3 AEs), using blood and stool samples.

Source: https://euclinicaltrials.eu/ctis-public/view/2023-505285-28-01